EU clinical trial 2022-502639-21-00: A Multicenter, Open-Label, Follow-Up Study to Assess the Long-Term Use of Oral Lacosamide in Study Participants Who Completed EP0034 or SP848 and Received Lacosamide Treatment
Protocol code: EP0151
Sponsor: UCB Biopharma (Pharmaceutical company). Phase: Therapeutic confirmatory (Phase III). Countries: Hungary (ended), Romania (ended).
Therapeutic area(s): Diseases [C] - Nervous System Diseases [C10]
Gender: Female, Male. Age: 0-17 years. Enrolment: 19.
Status: Ended. Start date (EU): 2020-12-28. End date (EU): 2025-02-11. End date: 2025-02-12. Decision date: 2023-03-27. Results received: Yes. Last updated: 2024-11-22.
Decision dates by country: RO: 2023-05-09, HU: 2023-03-27

Condition(s): Epilepsy
Product: lacosamide PRD236256

Primary endpoint: 1. Incidence of treatment-emergent adverse events (TEAEs) 2. Withdrawals from study due to TEAEs 3. Withdrawals from study due to Serious Adverse Event (SAEs) 4. Modal daily dose during the study 5. Maximum daily dose during the study

Source: https://euclinicaltrials.eu/ctis-public/view/2022-502639-21-00